EU clinical trial 2025-523858-13-01: High-dose Insulin Euglycemic Therapy in Non-Toxic Acute Cardiogenic Shock.
Protocol code: HIET-CS
Sponsor: Oslo Universitetssykehus HF (Hospital/Clinic/Other health care facility). Phase: Therapeutic exploratory (Phase II). Countries: Norway (authorised, recruitment pending).
Therapeutic area(s): Phenomena and Processes [G] - Circulatory and Respiratory Physiological Phenomena [G09]; Diseases [C] - Cardiovascular Diseases [C14]
Gender: Female, Male. Age: 18-64 years, 65+ years. Enrolment: 20.
Status: Authorised, recruitment pending. Decision date: 2026-07-01. Results received: No. Last updated: 2026-07-01.

Condition(s): Non-toxic acute cardiogenic shock
Product: Humalog 100 units/ml solution for injection in vial, Potassium Chloride MONICO 2 mEq/mL - concentrate for solution for infusion, 10 ampoules 10 mL, GLUCOSE 50 % AGUETTANT, solution pour perfusion

Primary endpoint: Primary exploratory efficacy endpoints at 48 hours - Changes from baseline to 48 hours in the following hemodynamic parameters using continuous pulmonary artery catheterization with thermodilution and blood sampling: cardiac output, pulmonary vascular resistance, svO2, P (v-a) CO2, lactate and N-terminal pro-B-type natriuretic peptide (NT-proBNP)., Primary exploratory efficacy endpoints at 48 hours - Changes from baseline to 48 hours in the following echocardiographic parameters: Left ventricular ejection fraction, left ventricular outflow tract velocity time integral (LVOT VTI) and E/e’., Primary exploratory efficacy endpoints at 48 hours - Changes from baseline in kidney function assessed by plasma creatinine-based estimated glomerular filtration rate (eGFR), plasma urea and urine output., Primary exploratory efficacy endpoints at 48 hours - Changes from baseline in heartrate, mean arterial blood pressure and Sequential Organ Failure Assessment (SOFA) score., Primary exploratory efficacy endpoints at 48 hours - Incident hemodynamically compromising arrhythmias assessed by continuous ECG-monitoring., Primary exploratory efficacy endpoints at 48 hours - Total dose of vasoactive drugs, inotropic drugs and diuretics., Exploratory long-term endpoints at 6 weeks - Survival free of mechanical circulatory support, Exploratory long-term endpoints at 6 weeks - Left ventricular ejection fraction assessed by echocardiography, Exploratory long-term endpoints at 6 weeks - Kidney function assessed by eGFR and plasma urea

Source: https://euclinicaltrials.eu/ctis-public/view/2025-523858-13-01